EU clinical trial 2024-514641-12-00: A Phase 3b Study to Evaluate Efficacy and Safety of a Single Dose of Autologous CRISPR Cas9 Modified CD34+ Human Hematopoietic Stem and Progenitor Cells (CTX001) in Subjects with Transfusion-Dependent β-Thalassemia or Severe Sickle Cell Disease
Protocol code: VX21-CTX001-161
Sponsor: Vertex Pharmaceuticals Inc. (Pharmaceutical company). Phase: Therapeutic confirmatory (Phase III). Countries: Germany (ongoing, recruiting), Italy (ongoing, recruiting).
Therapeutic area(s): Diseases [C] - Congenital, Hereditary, and Neonatal Diseases and Abnormalities [C16]
Gender: Female, Male. Age: 0-17 years, 18-64 years. Enrolment: 6.
Status: Ongoing, recruiting. Start date (EU): 2022-10-26. Decision date: 2024-07-12. Results received: No. Last updated: 2026-03-02.
Decision dates by country: IT: 2024-08-26, DE: 2024-07-12

Condition(s): Transfusion-dependent β-thalassemia (TDT), Severe sickle cell disease (SCD)
Product: PLERIXAFOR, Casgevy 4 - 13 x 10^6 cells/mL dispersion for infusion, BUSULFAN, FILGRASTIM

Primary endpoint: HbF and Hb levels over time. The evaluation will start 60 days after last RBC transfusion for post-transplant support or disease management.
Endpoint(s): TDT and SCD: Safety and tolerability of CTX001 based on adverse events (AEs), clinical laboratory values, neutrophil engraftment, platelet engraftment, transplant-related mortality (TRM), and all-cause mortality., TDT and SCD: Relative reduction from baseline in annualized volume of RBC transfusions, TDT and SCD: Proportion of alleles with intended genetic modification present in peripheral blood over time, TDT and SCD: Proportion of alleles with intended genetic modification present in CD34+ cells of the bone marrow over time, TDT: Duration transfusion free, SCD: Relative reduction from baseline in annualized rate of severe vaso-occlusive crises (VOCs) up to 12 months after CTX001 infusion. The evaluation starts 60 days after last RBC transfusion for post-transplant support or SCD disease management., SCD: Relative reduction from baseline in annualized rate of inpatient hospitalizations for severe VOCs up to 12 months after CTX001 infusion. The evaluation starts 60 days after last RBC transfusion for post-transplant support or SCD disease management., SCD: Relative reduction from baseline in annualized duration of hospitalization for severe VOCs up to 12 months after CTX001 infusion. The evaluation starts 60 days after last RBC transfusion for post-transplant support or SCD disease management., SCD: Relative reduction from baseline in markers of hemolysis up to 12 months after CTX001 infusion.

Source: https://euclinicaltrials.eu/ctis-public/view/2024-514641-12-00